EU clinical trial 2022-502393-16-00: I6T-MC-AMBZ - A Multicenter, Phase 3b, Open-Label, Single-Arm Study to Investigate Bowel Urgency and Its Relationship With Other Outcome Measures in Adults With Moderately to Severely Active Ulcerative Colitis Treated With Mirikizumab
Protocol code: I6T-MC-AMBZ
Sponsor: Eli Lilly & Co. (Pharmaceutical company). Phase: Therapeutic confirmatory (Phase III). Countries: Austria (ended), Slovakia (ended), Czechia (ended), France (ended), Germany (ended), Hungary (ended), Belgium (ended), Poland (ended), Italy (ended).
Therapeutic area(s): Diseases [C] - Digestive System Diseases [C06]
Gender: Female, Male. Age: 18-64 years, 65+ years. Enrolment: 116.
Status: Ended. Start date (EU): 2023-09-06. End date (EU): 2026-04-27. End date: 2026-04-27. Decision date: 2023-07-17. Results received: No. Last updated: 2026-05-26.
Decision dates by country: BE: 2023-07-24, DE: 2023-07-19, AT: 2023-07-24, IT: 2023-08-04, CZ: 2023-07-18, PL: 2023-07-24, HU: 2023-07-21, FR: 2023-07-17, SK: 2023-07-17

Condition(s): Moderately to Severely Active Ulcerative Colitis
Product: Mirikizumab, Mirikizumab

Primary endpoint: Change from baseline in bowel urgency severity (UNRS) score at Week 12.

Source: https://euclinicaltrials.eu/ctis-public/view/2022-502393-16-00